EU clinical trial 2022-501830-47-01: Monocentric Pilot Trial evaluating the safety and efficacy of Regorafenib in Arterio-Venous Malformations that are refractory to standard care
Protocol code: REGORAV
Sponsor: Cliniques Universitaires Saint-Luc (Hospital/Clinic/Other health care facility). Phase: Therapeutic exploratory (Phase II). Countries: Belgium (authorised, recruitment pending).
Therapeutic area(s): Diseases [C] - Congenital, Hereditary, and Neonatal Diseases and Abnormalities [C16]
Gender: Female, Male. Age: 18-64 years, 65+ years. Enrolment: 10.
Status: Authorised, recruitment pending. Decision date: 2025-04-23. Results received: No. Last updated: 2025-08-12.

Condition(s): Arterio-Venous Malformations
Product: REGORAFENIB

Primary endpoint: The efficacy assessment of regorafenib will be based on these following criteria : 1) Quality of life questionnaire adapted from OVAMA questionary with self-perception of improved quality of life (in %) 2) Evaluation of symptoms focused on pain. 3) Size of the lesion on the basis of clinical evaluation and the 12-month doppler ultrasonography, MRI and arteriography.
Endpoint(s): A secondary endpoint will explore the efficacy of regorafenib based on Functional limitation. The evaluation of functional limitation (difficulties in performing any action of everyday life) based on a scale ranging from 0 (no limitation) to 10 (excessive limitation).

Source: https://euclinicaltrials.eu/ctis-public/view/2022-501830-47-01